EU clinical trial 2023-504756-96-00: Therapeutic approach in Colchicine-resistant Recurrent pEricarditis in children: an open-label randomized trial comparing Anakinra vs sTEroids
Protocol code: The CREATE Trial
Sponsor: Giannina Gaslini Institute For Scientific Hospitalization And Care (Hospital/Clinic/Other health care facility). Phase: Therapeutic confirmatory (Phase III). Countries: Italy (ongoing, recruiting).
Therapeutic area(s): Diseases [C] - Immune System Diseases [C20]; Diseases [C] - Cardiovascular Diseases [C14]
Gender: Female, Male. Age: 0-17 years. Enrolment: 48.
Status: Ongoing, recruiting. Start date (EU): 2024-03-22. Decision date: 2023-10-23. Results received: No. Last updated: 2025-07-21.

Condition(s): Recurrent pericarditis, idiopathic or secondary to invasive cardiac procedures, not responsive to colchicine and NSAIDs after the first relapse.
Product: PREDNISONE, PREDNISONE, Kineret 100 mg/0.67 ml solution for injection in pre-filled syringe.

Primary endpoint: Complete response of disease flare at day 7, Lack of relapse at month 3
Endpoint(s): Time to achieve a complete control of the flare, Time to flare after treatment tapering, Number of flares at follow up, Behavior of acute phase reactants during 6 months of observation, Quality of life, Safety (registration of side effects occurred during the whole period of the study), Number of day of hospitalization, Transcriptomic study

Source: https://euclinicaltrials.eu/ctis-public/view/2023-504756-96-00